EU clinical trial 2025-523232-39-00: Anti-Ly6E Exatecan ADC M7437 in Advanced Solid Tumors
Protocol code: MS743701_0001
Sponsor: Merck Healthcare KGaA (Pharmaceutical company). Phase: Human Pharmacology (Phase I)- First administration to humans. Countries: Spain (authorised, recruitment pending).
Therapeutic area(s): Diseases [C] - Neoplasms [C04]
Gender: Female, Male. Age: 18-64 years, 65+ years. Enrolment: 14.
Status: Authorised, recruitment pending. Decision date: 2026-03-03. Results received: No. Last updated: 2026-03-13.

Condition(s): Advanced Solid Tumors

Source: https://euclinicaltrials.eu/ctis-public/view/2025-523232-39-00